EU clinical trial 2025-525009-18-00: A Randomized, Double-Blind, Phase 3 Study of Chemotherapy With or Without INCB161734 in Previously Untreated, KRAS G12D-Mutated Metastatic Pancreatic Ductal Adenocarcinoma (DAWN-303)
Protocol code: INCB161734-303
Sponsor: Incyte Corp. (Pharmaceutical company). Phase: Therapeutic confirmatory (Phase III). Countries: Poland (authorised, recruitment pending), Italy (authorised, recruitment pending), Netherlands (authorised, recruitment pending), Sweden (authorised, recruitment pending), Denmark (authorised, recruitment pending), Finland (authorised, recruitment pending), Spain (authorised, recruitment pending), France (not authorised), Germany (authorised, recruitment pending), Belgium (authorised, recruitment pending), Norway (authorised, recruitment pending), Austria (authorised, recruitment pending).
Therapeutic area(s): Diseases [C] - Neoplasms [C04]
Gender: Female, Male. Age: 18-64 years, 65+ years. Enrolment: 239.
Decision date: 2026-06-26. Results received: No. Last updated: 2026-07-13.
Decision dates by country: AT: 2026-06-29, BE: 2026-06-26, DK: 2026-06-29, FI: 2026-07-01, FR: 2026-07-01, DE: 2026-07-13, IT: 2026-06-30, ES: 2026-06-30, SE: 2026-06-29, NL: 2026-07-01, NO: 2026-06-29, PL: 2026-07-01

Condition(s): Pancreatic Ductal Adenocarcinoma
Product: IRINOTECAN, A placebo matching incb161734, INCB161734, OXALIPLATIN, Abraxane 5 mg/ml powder for dispersion for infusion., GEMCITABINE, FLUOROURACIL, CALCIUM FOLINATE HYDRATE

Primary endpoint: OS, defined as the time from the date of randomization to the date of death due to any cause. PFS by BICR, defined as the time from the date of randomization to the date of the first documented progression as determined by BICR per RECIST v1.1 or death due to any cause. Objective response by BICR, defined as a BOR of CR or PR as determined by BICR per RECIST v1.1.
Endpoint(s): DOR by BICR, defined as the time from the earliest date of documented response until the earliest date of disease progression as determined by BICR per RECIST v1.1 or death from any cause. Disease control by BICR, defined as having CR, PR, or SD as the best response determined by BICR per RECIST v1.1. PFS by investigator assessment, defined as the time from the date of randomization to the date of the first documented progression as determined by the investigator per RECIST v1.1, Objective response by investigator assessment, defined as a BOR of CR or PR as determined by the investigator per RECIST v1.1. • DOR by investigator assessment, defined as the time from the earliest date of documented response until earliest date of disease progression as determined by the investigator per RECIST v1.1 or death from any cause. • Disease control by investigator assessment, defined as having CR, PR, or SD as the best response as determined by the investigator per RECIST v1.1., AEs, assessed by physical examinations, evaluating changes in vital signs and ECGs, and through clinical laboratory blood sample evaluations. • Treatment interruptions, dose reductions, and discontinuation of study treatment due to AEs., HRQoL, assessed by changes from baseline in EORTC QLQ-C30, QLQ-PAN26, and EQ-5D-5L questionnaire scores., Plasma concentration of INCB161734., Blood and/or tumor analytes (which may include genomic analysis of cfDNA and proteomic measurement of markers in blood and genomic, transcriptomic, metabolomic, and/or proteomic markers in tumor tissue) that may correlate with clinical response or resistance to INCB161734 in combination with chemotherapy, Resource utilization associated with unplanned medical encounters.

Source: https://euclinicaltrials.eu/ctis-public/view/2025-525009-18-00